EU clinical trial 2023-509242-35-00: A randomized, controlled, open-label, phase III-trial on Adjuvant Dynamic marker - Adjusted Personalized Therapy comparing abemaciclib combined with standard adjuvant endocrine therapy versus standard adjuvant endocrine therapy in (clinical or genomic) intermediate to high risk, HR+/HER2- early breast cancer (ADAPTlate)
Protocol code: WSG-AM11
Sponsor: WSG Women's Cancer Study Group GmbH (Pharmaceutical company). Phase: Therapeutic confirmatory (Phase III). Countries: Germany (ongoing, recruitment ended), Spain (ongoing, recruitment ended), Poland (ongoing, recruitment ended).
Therapeutic area(s): Diseases [C] - Neoplasms [C04]
Gender: Female. Age: 18-64 years, 65+ years. Enrolment: 1624.
Status: Ongoing, recruitment ended. Start date (EU): 2020-07-23. Decision date: 2023-12-08. Results received: No. Last updated: 2026-08-04.
Decision dates by country: ES: 2024-07-12, DE: 2023-12-08, PL: 2024-07-29

Condition(s): HR+/HER2- early breast cancer
Product: ABEMACICLIB

Primary endpoint: iDFS since randomization
Endpoint(s): iDFS since primary diagnosis, OS and dDFS since randomization, OS and dDFS since primary diagnosis, occurrence of CNS metastases since randomization, occurrence of CNS metastases since primary diagnosis, subgroup and multivariable survival analyses defined by key clinical, genomic, and endocrine response parameters, patient reported outcomes, quality of life (EORTC QLQ-C30, EORTC QLQ-BR23, EQ-5D-5L), Efficacy of therapy according to distinct clinical and biological (measured by genomic signatures and other markers) prognostic subgroups

Source: https://euclinicaltrials.eu/ctis-public/view/2023-509242-35-00